EU clinical trial 2024-510966-18-00: A PHASE 2, OPEN-LABEL, SINGLE-ARM, MULTICOHORT, MULTICENTER TRIAL TO EVALUATE THE EFFICACY AND SAFETY OF JCAR017 IN ADULT SUBJECTS WITH RELAPSED OR REFRACTORY INDOLENT B-CELL NON-HODGKIN LYMPHOMA (NHL) (Transcend FL)
Protocol code: JCAR017-FOL-001
Sponsor: Celgene Corp. (Pharmaceutical company). Phase: Therapeutic exploratory (Phase II). Countries: Sweden (ongoing, recruitment ended), France (ongoing, recruitment ended), Spain (ongoing, recruitment ended), Austria (ended), Germany (ongoing, recruitment ended), Italy (ongoing, recruitment ended).
Therapeutic area(s): Diseases [C] - Immune System Diseases [C20]
Gender: Female, Male. Age: 18-64 years, 65+ years. Enrolment: 99.
Start date (EU): 2024-06-03. Decision date: 2024-06-03. Results received: No. Last updated: 2026-03-13.
Decision dates by country: ES: 2024-06-03, DE: 2024-06-24, SE: 2024-06-03, FR: 2024-06-10, AT: 2024-06-04, IT: 2024-06-26

Condition(s): Relapsed or refractory indolent B-cell Non-Hodgkin Lymphoma (NHL)
Product: Lisocabtagene maraleucel

Primary endpoint: Overall response rate (ORR) as assessed by PET-CT (FL) or CT (MZL) using "The Lugano Classification".
Endpoint(s): Complete response rate (CRR) as assessed by PET-CT (FL) or CT (MZL) using "The Lugano Classification"., Duration of Response (DOR) if Best Overall Response (BOR) is CR, as assessed by PET-CT and/or CT using "The Lugano Classification"., Duration of Response (DOR) as assessed by PET-CT and/or CT using "The Lugano Classification"., Progression Free Survival (PFS) as assessed by PET-CT and/or CT using "The Lugano Classification"., Overall Survival (OS), Safety, Pharmacokinetics (PK), Health-related quality of life (HRQoL)

Source: https://euclinicaltrials.eu/ctis-public/view/2024-510966-18-00